EU clinical trial 2022-502633-26-00: Perioperative treatment with Tranexamic Acid (TXA) in melanoma; prognostic and treatment related impact of the plasminogen-plasmin pathway
Sponsor: Aarhus University Hospital (Hospital/Clinic/Other health care facility). Phase: Therapeutic confirmatory (Phase III). Countries: Denmark (ongoing, recruiting).
Therapeutic area(s): Diseases [C] - Skin and Connective Tissue Diseases [C17]; Analytical, Diagnostic and Therapeutic Techniques and Equipment [E] - Therapeutics [E02]; Diseases [C] - Neoplasms [C04]
Gender: Female, Male. Age: 18-64 years, 65+ years. Enrolment: 638.
Status: Ongoing, recruiting. Start date (EU): 2023-08-25. Decision date: 2023-03-10. Results received: No. Last updated: 2026-07-28.

Condition(s): Melanoma Surgery
Product: PLACEBO, Pilexam, injektionsvæske, opløsning, Tablets Placebo, Tracafour, filmovertrukne tabletter

Primary endpoint: Histopathological confirmed relapse, defined as either local, regional (in transit or lymph node) or systemic relapses. Systemic metastases suspected on PET / CT/ MR will be used if a biopsy is not possible. We will calculate relapse risk proportions for each treatment arm as a binary outcome.
Endpoint(s): Adverse events, summarised according to grade: Mild: defined as the patient’s report of abdominal pain, diarrhoea or nausea. Severe: thromboembolic events, verified radiologically., Postoperative complications, summarised according to the type and postoperative timepoint, is defined as binary outcomes as bleeding, seroma or infection, Melanoma specific survival: defined as the period from the date of surgery (wide local excision and sentinel lymph node biopsy) to the date of death from suspected systemic melanoma (histopathological confirmed relapse or systemic metastases suspected on PET / CT / MR) or the date of completed 5 years follow-up., Overall survival: defined as the period from the date of surgery (re-excision and sentinel node) to the date of death from all causes or the date of finalised 5 years follow-up., Relapse free survival: defined as the period from the date of surgery (re-excision and sentinel node) to the date of histopathological confirmed relapse (local, regional or systemic), death from all causes or the data or completed 2 years follow-up.

Source: https://euclinicaltrials.eu/ctis-public/view/2022-502633-26-00